EU clinical trial 2024-517771-21-00: A Prospective Angiotensin II versus Noradrenaline trial for Hypotension management to reduce cardiac-surgery associated Acute Kidney Injury (PAN-AKI)
Protocol code: UniMs23_0019
Sponsor: Universitaet Muenster (Educational Institution). Phase: Phase III and phase IV (Integrated). Countries: Germany (ongoing, recruiting).
Therapeutic area(s): Analytical, Diagnostic and Therapeutic Techniques and Equipment [E] - Therapeutics [E02]
Gender: Female, Male. Age: 18-64 years, 65+ years. Enrolment: 1022.
Status: Ongoing, recruiting. Start date (EU): 2025-03-31. Decision date: 2025-02-06. Results received: No. Last updated: 2026-07-08.
Decision dates by country: DE: 2025-03-20

Condition(s): Acute kidney injury
Product: NOREPINEPHRINE, Giapreza 2.5 mg/ml concentrate for solution for infusion

Primary endpoint: Rate of AKI KDIGO stage 2 or 3 or death within 72 hours after cardiac surgery
Endpoint(s): MAKE90 (consisting of mortality, any dialysis within 90 days, persistent renal dysfunction (defined as > 25% eGFR reduction to baseline value at day 90), Development or progression of chronic kidney disease based on albuminuria and on two serum creatinine measurements between day 90 and 120

Source: https://euclinicaltrials.eu/ctis-public/view/2024-517771-21-00